EU clinical trial 2023-510509-17-00: A Phase 1/2 First in Human Study of the Menin-MLL (KMT2A) Inhibitor KO-539 in Patients with Relapsed or Refractory Acute Myeloid Leukemia
Protocol code: KO-MEN-001
Sponsor: Kura Oncology Inc. (Pharmaceutical company). Phase: Phase I and Phase II (Integrated)- First administration to humans. Countries: Spain (ongoing, recruitment ended), France (ongoing, recruitment ended), Belgium (ended), Italy (ongoing, recruitment ended), Germany (ended), Poland (ended).
Therapeutic area(s): Diseases [C] - Neoplasms [C04]
Gender: Female, Male. Age: 18-64 years, 65+ years. Enrolment: 145.
Start date (EU): 2020-06-17. Decision date: 2024-07-08. Results received: No. Last updated: 2026-01-16.
Decision dates by country: PL: 2024-07-15, BE: 2024-07-11, IT: 2024-07-15, FR: 2024-07-17, DE: 2024-07-09, ES: 2024-07-08

Condition(s): Relapsed and/or refractory Acute Myeloid Leukemia
Product: Ziftomenib, Ziftomenib

Primary endpoint: Phase 1 Part 1a: 1. Maximum Tolerated Dose (MTD), Phase 1 Part 1a: 2. Recommended Phase 2 dose (RP2D), Phase 1 Part 1b: 1. Safety, tolerability, and efficacy at multiple timepoints during the study, Phase 2: 1. Based on evaluation of CR/CRh, Sub-study 3: Safety, tolerability, and efficacy at multiple timepoints during the study, Sub study 4: Based on evaluation of CR/CRh, Sub study 2: PK parameters of ziftomenib and ziftomenib metabolites: AUC0-∞, AUC0-t, Cmax, Tmax, t1/2, CL/F, and Vz/F
Endpoint(s): Phase 1 Part 1a: 1. Safety/tolerability assessed at multiple timepoints during the study, Phase 1 Part 1a: 2. From blood samples collected at specified timepoints during treatment, Phase 1 Part 1a: 3. Plasma concentrations of ziftomenib and metabolite(s), Phase 1 Part 1a: 4. Plasma PK parameters (Cmax, Cmin, Tmax, AUC0-t, AUC0-8, CL/F, Vz/F, and t½), Phase 1 Part 1a: 5. Based on evaluation of (including but not limited to): a. Duration of CR/CRh, b. TI, c. CR/CRh MRD negativity, d. CRc (CR+ CRh + CRi), e. ORR (CR + CRh + CRi + MLFS), f. EFS, g. OS, Phase 1 Part 1b: 1. Based on evaluation of (including but not limited to): a. Duration of CR/CRh, b. TI, c. CR/CRh MRD negativity, d. CRc, e. EFS, f. OS, Phase 2: 1. Based on evaluation of (including but not limited to): a. Duration of CR/CRh, b. TI, c. CR/CRh MRD negativity, d. CRc e. EFS, f. OS, Phase 2: 2. Safety and tolerability assessed at multiple timepoints during the study, Sub-study 3: Based on evaluation of (including but not limited to): a. Rate of CR, b. Duration of CR, c. CR MRD negativity, d. Rate of CR/CRh/CRi, e. Duration of CR/CRh/CR, f. CR/CRh/CRi MRD negativity, g. EFS, h. OS, Sub-study 4: Based on evaluation of (including but not limited to): a. Duration of CR/CRh b. TI c. CR/CRh, CRc, and ORR MRD negativity d. CRc e. ORR f. EFS g.OS, Sub study 4: Safety, tolerability, and efficacy assessed at multiple timepoints during the study: a. Incidence and severity of AEs according to NCI CTCAE v5.0 b. Incidence of SAEs c. Deaths on treatment d. Discontinuations of study treatment due to AEs e. Clinically significant changes in clinical laboratory parameters, vital signs parameters, ECG parameters f. Change in ECOG status, Sub study 4: Plasma PK parameters (Cmax, Cmin, Tmax, AUC0-t, AUC0∞, CL/F, Vz/F, and t1/2), Sub study 2: QT interval corrected for heart rate using Fridericia’s formula and time-matched ziftomenib plasma concentration measurements

Source: https://euclinicaltrials.eu/ctis-public/view/2023-510509-17-00